EU clinical trial 2023-503251-10-00: A MULTICENTER, SINGLE-ARM, THREE COHORT, PHASE II TRIAL OF PATRITUMAB DERUXTECAN (HER3-DXD) IN PATIENTS WITH ACTIVE BRAIN METASTASES FROM HER3-EXPRESSING ADVANCED BREAST CANCER AND NON–SMALL CELL LUNG CANCER, AND IN PATIENTS WITH LEPTOMENINGEAL CARCINOMATOSIS FROM HER3-EXPRESSING ADVANCED SOLID TUMORS (The TUXEDO-3 Study)
Sponsor: Medica Scientia Innovation Research S.L. (Pharmaceutical company). Phase: Therapeutic exploratory (Phase II). Countries: Austria (ended), Spain (ended).
Therapeutic area(s): Diseases [C] - Neoplasms [C04]
Gender: Female, Male. Age: 18-64 years, 65+ years. Enrolment: 60.
Status: Ended. Start date (EU): 2023-10-10. End date (EU): 2026-04-03. Decision date: 2023-10-10. Results received: No. Last updated: 2026-04-14.
Decision dates by country: AT: 2023-10-10, ES: 2023-10-11

Condition(s): Metastatic Breast Cancer or Advanced Non-Small Cell Lung Cancer with asymptomatic untreated or progressing Brain Metastases, or solid tumors with Leptomeningeal disease
Product: Patritumab deruxtecan

Primary endpoint: Cohorts 1 and 2: ORR-IC, defined as the rate of patients with complete response (CR) or partial response (PR) determined locally by investigator, using RANO-BM criteria., Cohort 3: 3-month OS rate, defined as the rate of patients alive at 3 months after treatment start.
Endpoint(s): ORR, defined as the rate of patients with CR or PR centrally reviewed as per ESMO-European Association of Neuro-Oncology (EANO) for intracranial lesions in cohort 3 and RECIST v.1.1 for extracranial and overall lesions (bicompartmental ORR) in all cohorts., PFS, defined as the period from treatment initiation to the first occurrence of disease progression or death from any cause, whichever occurs first. It will be determined locally by investigator as per ESMO-EANO (cohort 3) and RANO-BM (cohort 1 and 2) for intracranial lesions and RECIST v.1.1 for extracranial and overall lesions., CBR, defined as the rate of patients with objective response (CR or PR), or stable disease for at least 24 weeks, as per ESMO-EANO (cohort 3) and RANO-BM (cohort 1 and 2) for intracranial lesions and RECIST v.1.1 for extracranial and overall lesions (bicompartmental CBR)., DCR, defined as the rate of patients with objective response (CR or PR), or stable disease (SD), as per ESMO-EANO (cohort 3) and RANO-BM (cohort 1 and 2) for intracranial lesions and RECIST v.1.1 for extracranial and overall lesions (bicompartmental DCR)., TTR, defined as the period from the treatment initiation to time of the first objective tumor response (tumor shrinkage of ≥ 30%) observed for patients who achieved a CR or PR, as per ESMO-EANO (cohort 3) and RANO-BM (cohort 1 and 2) for intracranial lesions and RECIST v.1.1 for extracranial and overall lesions., DOR, defined as the period from the first occurrence of a documented objective response to disease progression or death from any cause, observed for patients who achieved a CR or PR, as per ESMO-EANO (cohort 3) and RANO-BM (cohort 1 and 2) for intracranial lesions and RECIST v.1.1 for extracranial and overall lesions., Best percentage of change in tumor burden as per ESMO-EANO (cohort 3) and RANO-BM (cohort 1 and 2) for intracranial lesions and RECIST v.1.1 for extracranial and overall measurable lesions., OS, defined as the period from treatment initiation to death from any cause or last available follow-up., Safety and tolerability as per NCI-CTCAE v.5.0., Assessment of QoL with EORTC QLQ-C30, the brain specific tool (EORTC QLQ-BN20), and the breast specific tool EORTC QLQ-BR45., Neurocognitive function as per EORTC QLQ-C30, the brain specific tool (EORTC QLQ-BN20), and the breast specific tool EORTC QLQ-BR45., Neurologic function as per NANO scale., Exploratory endpoints: Efficacy endpoints according to HER3 expression levels and tumor type., Exploratory endpoints: Predictive and/or prognostic factors on blood/tumor samples., Exploratory endpoints: Efficacy endpoints for patients with and without prior ADC therapy., Exploratory endpoints Cohorts 1 and 2: Efficacy endpoints according to TROP2 expression levels., Exploratory endpoints Cohorts 1: The ER, PgR, and HER2 expression on baseline tissue samples and efficacy endpoints., Exploratory endpoints Cohorts 1: Efficacy endpoints for HER2+ breast cancer patients with and without prior tucatinib treatment., Exploratory endpoints Cohort 3: Predictive and/or prognostic factors on CSF (only if collected as per local guidelines and clinical routine).

Source: https://euclinicaltrials.eu/ctis-public/view/2023-503251-10-00